EU clinical trial 2024-517967-22-00: A Single Dose, Fast state, Crossover Replicate Bioequivalence Study of NITROFURANTOIN 100 mg prolonged-release capsules (IASIS PHARMA) vs.FURABID® 100 mg prolonged-release capsules (Amdipharm Limited)
Protocol code: NITRAIS 03/2024
Sponsor: Antibiotice S.A., Iasis Pharmaceuticals Hellas A.B.E.E. (Pharmaceutical company). Phase: Human Pharmacology (Phase I)- Bioequivalence Study. Countries: Romania (ended).
Therapeutic area(s): Diseases [C] - Male Urogenital Diseases [C12]; Diseases [C] - Female Urogenital Diseases and Pregnancy Complications [C13]; Diseases [C] - Bacterial Infections and Mycoses [C01]
Gender: Female, Male. Age: 18-64 years. Enrolment: 32.
Status: Ended. Start date (EU): 2025-02-25. End date (EU): 2025-03-31. Decision date: 2025-02-24. Results received: No. Last updated: 2025-02-24.

Condition(s): healthy subjects

Source: https://euclinicaltrials.eu/ctis-public/view/2024-517967-22-00